EU clinical trial 2024-513766-20-00: MAATEO: A phase 1 study in patients with hematological malignancies to evaluate safety, tolerability and efficacy of Karonudib
Sponsor: Oxcia AB, Thomas Helledays Stiftelse Foer Medicinsk Forskning, Oxcia AB (Pharmaceutical company, Laboratory/Research/Testing facility, Pharmaceutical company). Phase: Phase I and Phase II (Integrated)- Other. Countries: Sweden (ongoing, recruiting), Denmark (ongoing, recruiting).
Therapeutic area(s): Diseases [C] - Hemic and Lymphatic Diseases [C15]
Gender: Female, Male. Age: 18-64 years, 65+ years. Enrolment: 31.
Status: Ongoing, recruiting. Start date (EU): 2019-12-03. Decision date: 2024-04-29. Results received: No. Last updated: 2026-03-16.
Decision dates by country: DK: 2025-03-10, SE: 2024-04-29

Condition(s): Hematological malignancies
Product: IDARUBICIN HYDROCHLORIDE, KARONUDIB

Primary endpoint: Primary Objective Part I • To determine the safety and tolerability of Karonudib in escalating doses for the treatment of patients with advanced relapsed/refractory Acute Myeloid Leukemia (AML), Acute Lymphoblastic Leukemia (ALL) , Diffuse Large B-Cell Lymphoma, Multiple Myeloma (MM) and high-risk Myelodysplastic Syndrome (MDS) Primary Objective Part II To determine the safety and tolerability of Karonudib in combination with other anti-cancer agents for the treatment of patients with advance

Source: https://euclinicaltrials.eu/ctis-public/view/2024-513766-20-00